EU clinical trial 2023-509558-80-00: A prospective, randomized, and controlled study comparing two treatment strategies (Dose REduction of Antipsychotics vs. Maintenance treatment) in patients with schizophrenia spectrum disorder after Stratification based on patients’ psychotic PHENotype: a personalized medicine approach
Protocol code: DREAMS-PHEN
Sponsor: Les Hopitaux Universitaires De Strasbourg (Hospital/Clinic/Other health care facility). Phase: Therapeutic confirmatory (Phase III). Countries: France (authorised, recruitment pending).
Therapeutic area(s): Psychiatry and Psychology [F] - Mental Disorders [F03]
Gender: Female, Male. Age: 18-64 years. Enrolment: 288.
Status: Authorised, recruitment pending. Decision date: 2025-05-12. Results received: No. Last updated: 2026-02-26.
Decision dates by country: FR: 2025-07-17

Condition(s): Patient with a diagnosis of schizophrenia spectrum disorder (SSD): schizophrenia, schizophreniform, schizoaffective disorder or brief psychotic episode according to DSM-5
Product: RISPERIDONE, FLUPENTIXOL, LEVOMEPROMAZINE, CHLORPROMAZINE, LOXAPINE, FLUPENTIXOL DECANOATE, QUETIAPINE, AMISULPRIDE, ARIPIPRAZOLE, PIPOTIAZINE PALMITATE, PIPOTIAZINE, HALOPERIDOL, ZUCLOPENTHIXOL, OLANZAPINE

Primary endpoint: Percentage of patients with functional remission as defined by a PSP (Personal and Social Performance Scale, Nasrallah et al. 2008) score >70 at 24 months follow-up (study endpoint)., The PSP will be assessed at different times of the study, both by the treating psychiatrist of the patients (i.e. who is not blind to patients’ treatment arm) and by the Dreams-Phen evaluation team (who will be blind to patients’ treatment arm). The primary endpoint will rely ONLY on the PSP scores at 24 months assessed by the Dreams-Phen evaluation team., This evaluation will be performed during a webmeeting with the patient and his/her caregiver and will be based on the patient’s functioning during the month preceding the evaluation.
Endpoint(s): Functional remission as defined by a PSP (Personal and Social Performance Scale, Nasrallah et al., 2008) score >70 at 24 months follow-up (study endpoint) and as assessed by the Dreams-Phen evaluation team., Clinical symptoms will be assessed with the short form of the PANSS (PANSS-6) and will be used by the treating psychiatrists as well as the Dreams-Phen evaluation team at some assessment points for time purposes. Illness severity will be assessed with the Clinical Global Impression (CGI)., A relapse will be defined by either as: a) a new hospitalization due to exacerbation of symptoms b) aggressive behavior c) suicidal attempt, At the end of the study, a structured interview (inspired by that used in the Radar study; Moncrieff et al. 2019) will be conducted with the patients and his/her caregivers and sent to the treating psychiatrist, in order to confirm the presence or absence of any relapse during the period of the study, Therapeutic efficacy index will be assessed with the CGI-difference and adherence to treatment with the MARS (Thompson et al., 2000) from the patient side and the BARS (Byerly et al., 2008) from the psychiatrist side. In addition, drug monitoring will be proposed, in order to check adherence to treatment and to ensure patients’ compliance to the treatment arm., Treatment side-effects will be assessed using the Abnormal Involuntary Movement Scale (AIMS), and Simpson & Angus Scale (SAS), and using the body mass index and biological measures to assess metabolic syndrome. Cognitive functioning will be assessed with subjective scales SSTICS and cognitive tests completed online using Millisecond softwares. Subjective well-being under antipsychotics will be assessed by means of the SWN-SF., Global and social functioning will be assessed using the GAF, the PSP total score and the EPHP (rated by the caregivers). Quality of life will be assessed using the S-QoL and the EQ-5D-5L (EuroQoL-5D) and the recovery process by means of the Questionnaire about the Process of Recovery (QPR)., The influence of specific patient characteristics on our primary outcome will be assessed, in particular, the level of interaction between treatment intervention and phenotype and: a) the history of psychotic episodes (i.e. patients with first or multiple psychotic episode(s)) b) the presence/absence of current substance abuse disorder (this will not represent an exclusion criteria); similar to Radar and Hamlett studies., Practically, if a patient presents with a transient increase of psychotic symptoms during a step X of the DR schema, we will estimate that the individual minimal effective dose (i-MinED) is that corresponding to the dose given during the previous step (X-1) in the DR protocol., Significant relapse and PSP, 3 months after reaching the MinED., Mean antipsychotic dosage at study endpoint in each arm (as expressed in eqOlz and in % of D2-R occupancy)

Source: https://euclinicaltrials.eu/ctis-public/view/2023-509558-80-00